EU clinical trial 2024-512546-42-00: Botulinum toxin injection in the upper esophageal sphincter for retrograde-cricopharyngeus dysfunction: a double blind, placebo-controlled trial.
Protocol code: 52082
Sponsor: Algemeen Ziekenhuis Delta (Hospital/Clinic/Other health care facility). Phase: Therapeutic use (Phase IV). Countries: Belgium (ongoing, recruiting).
Therapeutic area(s): Diseases [C] - Digestive System Diseases [C06]; Diseases [C] - Otorhinolaryngologic Diseases [C09]
Gender: Female, Male. Age: 18-64 years. Enrolment: 44.
Status: Ongoing, recruiting. Start date (EU): 2024-09-02. Decision date: 2024-07-15. Results received: No. Last updated: 2025-06-13.
Decision dates by country: BE: 2024-08-27

Condition(s): retrograde cricopharyngeus dysfunction
Product: Saline Solution Basi 9 mg/ml solution for infusion, BOTOX 100 Allergan Units Powder for solution for injection

Primary endpoint: Response to Botox versus placebo, 12 weeks after treatment. We will use the questionnaire of ‘Difficulties with belching’, and response is defined as at least a 50% improvement on question 6A ‘To what extent have the symptoms of 'difficulty burping air' been reduced after treatment?'.
Endpoint(s): Response to Botox versus placebo, 48 weeks after treatment. We will use the questionnaire of ‘Difficulties with belching’, and response is defined as at least a 50% improvement on question 6A ‘To what extent have the symptoms of 'difficulty burping air' been reduced after treatment?'., Safety: assessed by the number and type of (serious) adverse events that occurred in each group by week 48, and by the SSQ 1 week and 4 weeks after the procedure., Exploratory: HRQOL using EQ-5D VAS score short-term (1, 4, 12 weeks) and long-term (30 - 48 weeks after the procedure)., Exploratory: Patients experience and satisfaction of the treatment based on OTE and OSS short-term (1, 4, 12 weeks after the procedure), and long-term (20 - 48 weeks after the procedure), Exploratory: Evolution of associated gastro-intestinal symptoms short-term (1, 4, 12 weeks) and long-term (20 - 48 weeks after the procedure)., Exploratory: Change in objective measurements after, versus before BT injeciton using high resolution impedance manometry at week 20, and comparing with baseline., Exploratory: Improvement in symptoms after Botox versus placebo, 12 and 48 weeks after treatment. We will use the questionnaire of ‘Difficulties with belching’, using a cut-off for improvement of 30% on question 6A ‘To what extent have the symptoms of 'difficulty burping air' been reduced after treatment?'., Exploratory: Safety at week 12, 20 and 48 using SSQ

Source: https://euclinicaltrials.eu/ctis-public/view/2024-512546-42-00